EU clinical trial 2024-512421-92-00: A Phase 1/2, Multicenter, Open Label, Dose Escalation and Dose Expansion Study of JK06, a 5T4 Antibody Drug Conjugate, in Patients with Unresectable Locally Advanced or Metastatic Cancer
Protocol code: JK06.1.01
Sponsor: Salubris Biotherapeutics Inc. (Pharmaceutical company). Phase: Phase I and Phase II (Integrated)- First administration to humans. Countries: Belgium (ongoing, recruiting), Spain (ongoing, recruiting).
Therapeutic area(s): Diseases [C] - Neoplasms [C04]
Gender: Female, Male. Age: 18-64 years, 65+ years. Enrolment: 305.
Status: Ongoing, recruiting. Start date (EU): 2025-10-14. Decision date: 2024-07-18. Results received: No. Last updated: 2026-05-05.
Decision dates by country: ES: 2024-11-27, BE: 2024-07-18

Condition(s): Unresectable, Locally Advanced or Metastatic Cancer

Primary endpoint: For Dose Escalation : MTD/OBD and/or DLT during the DLT evaluation period and all serious adverse events, adverse events tabulated/reported by type, grade, and frequency for the entire study duration., For Cohort Expansion: • RP2D based on the totality of the data and primarily based on the ORR and AE & SAE. • ORR according to RECIST 1.1 (Eisenhauser 2009) or PCWG3 criteria (Scher 2016).
Endpoint(s): For dose Escalation : •PK (analysis of Cmax, AUC, Tmax, and t½ following treatment completion). • ADA status. • ORR according to standard RECIST 1.1 criteria (Eisenhauer 2009)., For Cohort Expansion: •Evaluate DoR, DCR, and PFS according to RECIST 1.1 (Eisenhauer 2009) or PCWG3 criteria (Scher 2016). • Evaluate AEs/SAEs tabulated by tumor type. • PK (analysis of maximum observed drug concentration [Cmax], AUC, time to maximum observed drug concentration (Tmax), and terminal elimination half-life (t½) following treatment completion) evaluation by dose and tumor type.

Source: https://euclinicaltrials.eu/ctis-public/view/2024-512421-92-00